EU clinical trial 2025-521242-26-00: Phase 2 Platform Trial to Assess the Efficacy and Safety of Long-acting Antibodies as Single Agents and in Combinations for Moderately to Severely Active Ulcerative Colitis
Protocol code: SPY123-201
Sponsor: Spyre Therapeutics Inc. (Pharmaceutical company). Phase: Therapeutic exploratory (Phase II). Countries: Belgium (ongoing, recruiting), Hungary (ongoing, recruiting), Lithuania (authorised, recruiting), Netherlands (not authorised), Croatia (ongoing, recruiting), Czechia (ongoing, recruiting), Bulgaria (ongoing, recruiting), Romania (ongoing, recruiting), Spain (authorised, recruiting), France (ongoing, recruiting), Austria (ongoing, recruiting), Italy (ongoing, recruiting), Greece (ongoing, recruiting), Poland (ongoing, recruiting), Germany (ongoing, recruiting), Slovakia (ongoing, recruiting).
Therapeutic area(s): Diseases [C] - Digestive System Diseases [C06]
Gender: Female, Male. Age: 18-64 years, 65+ years. Enrolment: 238.
Start date (EU): 2025-11-27. Decision date: 2025-11-10. Results received: No. Last updated: 2026-05-07.
Decision dates by country: AT: 2025-11-17, BE: 2025-11-12, BG: 2025-11-14, HR: 2025-11-17, CZ: 2025-11-13, FR: 2025-11-14, DE: 2025-11-12, GR: 2025-11-11, HU: 2025-11-17, IT: 2025-11-12, LT: 2025-11-12, RO: 2025-11-17, ES: 2025-11-17, NL: 2025-11-13, PL: 2025-11-15, SK: 2025-11-10

Condition(s): Moderately to Severely Active Ulcerative Colitis
Product: SPYPBO-102, SPYPBO-101, SPY002, SPY002, SPY001-001, SPY001-001

Primary endpoint: Part A: Change in RHI from baseline at Week 12., Part B: Clinical remission at Week 12.
Endpoint(s): Part A: 1. Clinical remission at Week 12., Part A: 2. Endoscopic improvement at Week 12., Part A: 3. Change in modified Mayo score from baseline at Week 12., Part A: 4. Study drug concentration through Week 12., Part A: 5. Percentage of participants with ADAs to study drug(s) through Week 12., Part B: 1. Endoscopic improvement at Week 12., Part B: 2. Clinical response at Week 12., Part B: 3. Histologic improvement at Week 12., Part B: 4. HEMI at Week 12., Part B: 5. Clinical remission at Week 48., Part B: 6. Study drug concentration through Week 12., Part B: 7. Percentage of participants with ADA to study drug(s) through Week 12.

Source: https://euclinicaltrials.eu/ctis-public/view/2025-521242-26-00